EU clinical trial 2024-517638-16-00: 18F-DPA714 PET-MRI study to improve preoperative localisation of the epileptic focus to be resected in drug-resistant partial epilepsy
Sponsor: Commissariat a l'Energie Atomique et aux Energies Alternatives (Laboratory/Research/Testing facility). Phase: Human Pharmacology (Phase I)- Other. Countries: France (ended).
Therapeutic area(s): Analytical, Diagnostic and Therapeutic Techniques and Equipment [E] - Diagnosis [E01]
Gender: Female, Male. Age: 0-17 years, 18-64 years. Enrolment: 50.
Status: Ended. Start date (EU): 2024-11-04. End date (EU): 2025-11-05. Decision date: 2024-11-04. Results received: Yes. Last updated: 2024-11-04.

Condition(s): Patients with drug-resistant epilepsy who are candidates for surgery requiring SEEG.
Product: 18F-DPA-714

Primary endpoint: Percentage of subjects in whom the epileptogenic volume defined by SEEG performed according to the electrode implantation plan determined with multimodal PET-MRI imaging (VE2) will have been correctly modified compared with the electrode implantation plan determined without multimodal imaging data (VE1).
Endpoint(s): Collection and analysis of adverse events and their causal relationship in relation to the entire procedure evaluated., Number of subjects who benefited from the entire procedure in accordance with the protocol., Number of seizures in patients 1 year after surgery (ILAE classification)., Study of imaging results in subgroups of patients according to the type epilepsy (temporal or extra-temporal localization, etiology of epilepsy epilepsy, seizure frequency)., Imaging data in patients not cured by surgery., Imaging data in patients rejected after SEEG., Topography of PET imaging data 18F-DPA-714 PET vs. MRI data., Relationship between epileptic focus and remote brain function.

Source: https://euclinicaltrials.eu/ctis-public/view/2024-517638-16-00